EU clinical trial 2023-505806-41-00: A study of the safety and efficacy of MB-dNPM-1-TCR.1 in patients with relapsed or refractory AML.
Protocol code: M-2020-358
Sponsor: Miltenyi Biomedicine GmbH (Pharmaceutical company). Phase: Phase I and Phase II (Integrated)- First administration to humans. Countries: Netherlands (ongoing, recruiting).
Therapeutic area(s): Diseases [C] - Hemic and Lymphatic Diseases [C15]; Diseases [C] - Neoplasms [C04]
Gender: Female, Male. Age: 18-64 years, 65+ years. Enrolment: 32.
Status: Ongoing, recruiting. Start date (EU): 2024-08-01. Decision date: 2023-12-18. Results received: No. Last updated: 2026-03-30.

Condition(s): Acute myeloid leukemia

Source: https://euclinicaltrials.eu/ctis-public/view/2023-505806-41-00